EU clinical trial 2023-504116-14-00: A randomized, open-label, single dose, 2-way crossover bioequivalence study comparing ticagrelor 90 mg hard capsules (PG402 [Celon Pharma]) vs ticagrelor 90 mg film-coated tablets (Brilique [AstraZeneca AB]) under fasting conditions in healthy volunteers
Protocol code: 01TICA2023
Sponsor: Celon Pharma S.A. (Pharmaceutical company). Phase: Human Pharmacology (Phase I)- Bioequivalence Study. Countries: Poland (ended).
Therapeutic area(s): Diseases [C] - Cardiovascular Diseases [C14]
Gender: Female, Male. Age: 18-64 years. Enrolment: 40.
Status: Ended. Start date (EU): 2023-10-17. End date (EU): 2023-12-14. Decision date: 2023-10-16. Results received: Yes. Last updated: 2023-10-16.

Condition(s): Prevention of atherothrombotic events in adult patients with - acute coronary syndromes (ACS) or - a history of myocardial infarction (MI) and a high risk of developing an atherothrombotic event
Product: PG402, Brilique 90 mg film-coated tablets

Primary endpoint: Cmax and AUC(0-t) for ticagrelor
Endpoint(s): AUC0-∞, AUC_%Extrap_obs, tmax, λz, t1/2 for ticagrelor

Source: https://euclinicaltrials.eu/ctis-public/view/2023-504116-14-00